EU clinical trial 2024-515127-11-00: A randomized open-label phase II study on the effect of durvalumab and tremelimumab combined with personalized SIRT (p-SIRT), standard-dose SIRT (sd-SIRT) or immunotherapy followed by on-demand loco-regional SIRT (od-SIRT) in non-resectable hepatocellular carcinoma (HCC) patients
Protocol code: ESR-19-14451
Sponsor: Klinikum der Universitaet Muenchen AöR (Hospital/Clinic/Other health care facility). Phase: Therapeutic exploratory (Phase II). Countries: Germany (ongoing, recruiting), Italy (ongoing, recruiting).
Therapeutic area(s): Diseases [C] - Neoplasms [C04]
Gender: Female, Male. Age: 18-64 years, 65+ years. Enrolment: 64.
Status: Ongoing, recruiting. Start date (EU): 2023-12-21. Decision date: 2024-08-02. Results received: No. Last updated: 2026-07-15.
Decision dates by country: IT: 2025-03-28, DE: 2024-09-06

Condition(s): hepatocellular carcinoma
Product: DURVALUMAB, TREMELIMUMAB

Primary endpoint: Objective Response Rate (ORR compared to SIRT historical control)
Endpoint(s): Overall survival (OS), Progression-free survival (PFS), Complete response rate (CRR), Disease control rate (DCR), Duration of response (DoR), Time to deterioration of liver function, defined as time from randomization to worsening of CTCAE grade compared with baseline and persisting for ≥30 days for any of these parameters: aspartate aminotransferase (AST), alanine aminotransferase (ALT), total bilirubin, albumin, and international normalized ratio (INR); separately for patients in Arm A and Arm B, Time to locally/locoregional untreatable progression (TTuP), defined as time from randomization to occurrence of any of the following conditions: progression which would require targeting of more than 3 pretreated lesions as determined by the latest staging investigation, progression occurring due to diffuse tumor growth, occurrence of vascular invasion, occurrence of extrahepatic spread, worsening of liver function to Child-Pugh score 8 or higher, Time to stage progression (defined as time from randomization to disease progression to BCLC C), To assess the quality of life (QoL), as determined by the EORTC QLQ-C30 and EORTC QLQ-HCC18 questionnaires.

Source: https://euclinicaltrials.eu/ctis-public/view/2024-515127-11-00